EU clinical trial 2024-514210-12-00: Leflunomide in PMR; A multicenter randomized placebo controlled treatment study of Leflunomide in polymyalgia rheumatica
Sponsor: Universitair Medisch Centrum Groningen (Hospital/Clinic/Other health care facility). Phase: Therapeutic confirmatory (Phase III). Countries: Netherlands (ongoing, recruiting).
Therapeutic area(s): Diseases [C] - Immune System Diseases [C20]
Gender: Female, Male. Age: 18-64 years, 65+ years. Enrolment: 94.
Status: Ongoing, recruiting. Start date (EU): 2024-09-01. Decision date: 2024-08-12. Results received: No. Last updated: 2024-08-12.

Condition(s): polymyalgia rheumatica
Product: Leflunomide Mylan 10 mg, filmomhulde tabletten, PLACEBO

Primary endpoint: the time to the first relapse at 12 months

Source: https://euclinicaltrials.eu/ctis-public/view/2024-514210-12-00